EU clinical trial 2023-504196-24-00: An Open-label, Randomized, Active-Controlled, Phase 3 Study of Setrusumab Compared With Bisphosphonates in Pediatric Subjects With Osteogenesis Imperfecta Types I, III or IV
Protocol code: UX143-CL314
Sponsor: Ultragenyx Pharmaceutical Inc. (Pharmaceutical company). Phase: Therapeutic confirmatory (Phase III). Countries: Netherlands (ongoing, recruitment ended), Germany (ended), Italy (ongoing, recruitment ended), Poland (ongoing, recruitment ended), France (ended).
Therapeutic area(s): Diseases [C] - Musculoskeletal Diseases [C05]
Gender: Female, Male. Age: 0-17 years. Enrolment: 27.
Start date (EU): 2023-10-17. Decision date: 2023-08-21. Results received: No. Last updated: 2026-05-21.
Decision dates by country: DE: 2023-08-23, FR: 2023-08-25, PL: 2023-08-28, IT: 2023-08-23, NL: 2023-08-21

Condition(s): osteogenesis imperfecta
Product: Zoledronate EG 5 mg/100 ml solution pour perfusion, PAMIFOS-60, 60 mg, proszek i rozpuszczalnik do sporządzania roztworu do infuzji, PAMIFOS-30, 30 mg, proszek i rozpuszczalnik do sporządzania roztworu do infuzji, PAMIFOS-90, 90 mg, proszek i rozpuszczalnik do sporządzania roztworu do infuzji, Pamidronate disodique Hospira 3 mg / ml solution à diluer pour perfusion, Aclasta 5 mg solution for infusion, Pamidronate disodique Hospira 9 mg / ml solution à diluer pour perfusion, Zoledronate EG 5mg/100ml Infusionslösung, NERIXIA 100 mg concentrato per soluzione per infusione, Zoledronate EG 4 mg/100 ml solution pour perfusion, Aclasta 5 mg solution for infusion, Aclasta 5 mg solution for infusion, PAMIDRONATE DE SODIUM HOSPIRA 6 mg/ml, solution à diluer pour perfusion, Pamidronate disodique Hospira 3 mg / ml solution à diluer pour perfusion, Setrusumab, NERIXIA 25 mg soluzione iniettabile, Pamidronaatdinatrium Hospira 6 mg/ml concentraat voor oplossing voor infusie, Pamidronaatdinatrium Hospira 9 mg/ml concentraat voor oplossing voor infusie, Pamidronate Disodium 3 mg/ml Sterile Concentrate, Pamidronate disodique Hospira 6 mg / ml solution à diluer pour perfusion, PAMIDRONATE DE SODIUM HOSPIRA 9 mg/ml, solution à diluer pour perfusion

Primary endpoint: Annualized rate of all radiographically-confirmed fractures, including morphometric vetrebral fractures at the primary analysis
Endpoint(s): Annualized rate of radiographically-confirmed fractures, excluding morphometric vertebral fractures,but including fractures of the fingers, toes, face, and skull at the primary analysis, Change from baseline in Pediatric Orthopedic Society of North America Pediatric Outcomes Data Collection Instrument (POSNA-PODCI) Sports/Physical Functioning and Pain/Comfort subscale scores at the primary analysis, Serum setrusumab concentration at scheduled time points, Frequency, severity, and relationship to treatment of treatment-emergent adverse events (TEAEs), serious adverse events (SAEs), and adverse events of special interest (AESIs), Incidence of binding and neutralizing anti-setrusumab antibodies at scheduled time points, Percent change from baseline in DXA BMD at the lumbar spine at the primary analysis, Annualized rate of all radiographically-confirmed fractures, excluding morphometric vertebral fractures and fractures of the fingers, toes, face, and skull, at the primary analysis, Change from baseline in dual-energy X-ray absorptiometry (DXA) bone mineral density (BMD) zscore at the lumbar spine at the primary analysis, Proportion of subjects experiencing new radiographically-confirmed fractures, including morphometric vertebral fractures, at the primary analysis

Source: https://euclinicaltrials.eu/ctis-public/view/2023-504196-24-00